EU clinical trial 2025-521216-19-00: A Global, Phase 3, Multicenter, Open-Label Study to Assess the Long-Term Safety and Tolerability of NBI-1117568 in Adults with Schizophrenia
Protocol code: NBI-1117568-SCZ3032
Sponsor: Neurocrine Biosciences Inc. (Pharmaceutical company). Phase: Therapeutic confirmatory (Phase III). Countries: Romania (ongoing, recruiting), Hungary (authorised, recruitment pending), Bulgaria (ongoing, recruiting).
Therapeutic area(s): Psychiatry and Psychology [F] - Mental Disorders [F03]
Gender: Female, Male. Age: 18-64 years, 65+ years. Enrolment: 154.
Start date (EU): 2025-12-10. Decision date: 2025-11-21. Results received: No. Last updated: 2026-06-01.
Decision dates by country: HU: 2025-11-24, RO: 2025-11-21, BG: 2025-11-21

Condition(s): Schizophrenia, Schizophrenia
Product: NBI-1117568, NBI-1117568

Primary endpoint: Occurrence of AEs during the Open-Label Treatment Period

Source: https://euclinicaltrials.eu/ctis-public/view/2025-521216-19-00